EU clinical trial 2022-501624-14-00: WALKALS : A pilot phase II study to evaluate the effect of salbutamol on walking capacity in ambulatory ALS patients.
Protocol code: APHP190724
Sponsor: Assistance Publique Hopitaux De Paris (Hospital/Clinic/Other health care facility). Phase: Therapeutic exploratory (Phase II). Countries: France (expired).
Therapeutic area(s): Diseases [C] - Nervous System Diseases [C10]
Gender: Female, Male. Age: 18-64 years, 65+ years. Enrolment: 36.
Status: Expired. Decision date: 2023-05-05. Results received: Yes. Last updated: 2023-08-18.

Condition(s): Amyotrophic Lateral Sclerosis (ALS)
Product: Ventoline 0,4 mg/ml oral lösning, Placebo of salbutamol

Primary endpoint: Two primary endpoints will be used: change from baseline of the 6 minutes walking test distance (6MWT) at M3 (2mg TID) and at M6 (4mg TID) with type I error controlled through Bonferroni correction.

Source: https://euclinicaltrials.eu/ctis-public/view/2022-501624-14-00